EU clinical trial 2024-514014-13-00: MidOStaurin + Gemtuzumab OzogAmIcin Combination in First-line Standard Therapy for Acute Myeloid Leukemia (MOSAIC)
Protocol code: TUD-MOSAIC-075
Sponsor: Technische Universitaet Dresden (Educational Institution). Phase: Phase I and Phase II (Integrated)- Other. Countries: Germany (ongoing, recruiting).
Therapeutic area(s): Diseases [C] - Neoplasms [C04]
Gender: Female, Male. Age: 18-64 years, 65+ years. Enrolment: 214.
Status: Ongoing, recruiting. Start date (EU): 2020-09-02. Decision date: 2024-11-08. Results received: No. Last updated: 2026-04-28.

Condition(s): female and male adult patients with acute myeloid leukemia
Product: Rydapt 25 mg soft capsules, CYTARABINE, Rydapt 25 mg soft capsules, MYLOTARG 5 mg powder for concentrate for solution for infusion, DAUNORUBICIN HYDROCHLORIDE

Primary endpoint: Primary endpoint dose escalation part (phase I, MODULE): Maximum tolerated dose (MTD) of midostaurin and GO in combination, Primary endpoint expansion part (phase II in CBF AML, MAGNOLIA): Event-free survival; event is being defined as either primary treatment failure or relapse or death, whichever occurs first, Primary endpoint expansion part (phase II in FLT3mut AML, MAGMA): Event-free survival; event is being defined as either primary treatment failure or relapse or death, whichever occurs first

Source: https://euclinicaltrials.eu/ctis-public/view/2024-514014-13-00